EU clinical trial 2025-523488-39-00: Randomised, placebo-controlled, double-blind, parallel-group Phase II study to evaluate the efficacy and safety of oral BI 3000202 in patients with moderate to severe systemic lupus erythematosus (SLE)
Protocol code: 1509-0004
Sponsor: Boehringer Ingelheim International GmbH, Boehringer Ingelheim Espana S.A. (Pharmaceutical company). Phase: Therapeutic exploratory (Phase II). Countries: Bulgaria (authorised, recruiting), Romania (authorised, recruitment pending), Germany (authorised, recruiting), Spain (ongoing, recruiting), Hungary (authorised, recruitment pending), Poland (ongoing, recruiting), Croatia (authorised, recruitment pending).
Therapeutic area(s): Diseases [C] - Immune System Diseases [C20]
Gender: Female, Male. Age: 18-64 years, 65+ years. Enrolment: 106.
Start date (EU): 2026-06-02. Decision date: 2026-05-04. Results received: No. Last updated: 2026-08-05.
Decision dates by country: HR: 2026-05-08, RO: 2026-05-11, PL: 2026-05-08, BG: 2026-05-07, ES: 2026-05-04, HU: 2026-05-12, DE: 2026-05-12

Condition(s): Systemic lupus erythematosus
Product: Placebo matching BI 3000202, BI 3000202, BI 3000202

Primary endpoint: Achievement of a Systemic Lupus Erythematosus Responder Index (SRI)-4 response at Week 32
Endpoint(s): Achievement of SRI-4 response at Week 52, Achievement of SRI-4 response and oral corticosteroid reduction to ≤5 mg/day prednisone or equivalent at Week 32, Achievement of Lupus Low Disease Activity State (LLDAS) at Week 32

Source: https://euclinicaltrials.eu/ctis-public/view/2025-523488-39-00